EU clinical trial 2023-507225-42-00: An Open-Label, Multicenter, Rollover Study to Enable Continued Treatment Access for Subjects Previously Enrolled in Studies of Ruxolitinib
Protocol code: INCB 18424-270
Sponsor: Incyte Corp. (Pharmaceutical company). Phase: Therapeutic exploratory (Phase II). Countries: Poland (ongoing, recruiting).
Therapeutic area(s): Diseases [C] - Neoplasms [C04]
Gender: Female, Male. Age: 18-64 years, 65+ years. Enrolment: 6.
Status: Ongoing, recruiting. Start date (EU): 2024-11-05. Decision date: 2024-05-31. Results received: No. Last updated: 2026-07-30.

Condition(s): Myelofibrosis
Product: Jakavi 5 mg tablets, Jakavi 15 mg tablets

Primary endpoint: To assess the frequency and types of adverse events and serious adverse events reported in subjects receiving ruxolitinib alone, ruxolitinib plus background cancer therapy, or background cancer therapy alone.

Source: https://euclinicaltrials.eu/ctis-public/view/2023-507225-42-00